EU clinical trial 2023-504996-26-00: A Phase III Double-Blind, Randomised, Placebo-Controlled Study Assessing the Efficacy and Safety of Capivasertib + Docetaxel Versus Placebo + Docetaxel as Treatment for Patients with Metastatic Castration Resistant Prostate Cancer (mCRPC)
Protocol code: D361EC00001
Sponsor: AstraZeneca AB (Pharmaceutical company). Phase: Therapeutic confirmatory (Phase III). Countries: Poland (ended), Czechia (ended), Spain (ongoing, recruitment ended), France (ended), Belgium (ended), Greece (ongoing, recruitment ended), Hungary (ended), Netherlands (ended).
Therapeutic area(s): Diseases [C] - Neoplasms [C04]
Gender: Male. Age: 18-64 years, 65+ years. Enrolment: 424.
Start date (EU): 2022-07-21. Decision date: 2024-08-06. Results received: No. Last updated: 2025-11-25.
Decision dates by country: NL: 2024-08-06, GR: 2024-08-22, CZ: 2024-08-07, ES: 2024-08-07, PL: 2024-08-09, BE: 2024-08-06, HU: 2024-08-06, FR: 2024-08-07

Condition(s): Metastatic Castration Resistant Prostate Cancer (mCRPC)
Product: Placebo to capivasertib, Capivasertib, Bendadocel 20 mg/ml Konzentrat zur Herstellung einer Infusionslösung, Docetaxel Accord 80 mg/4 ml concentrate for solution for infusion, Capivasertib, Docetaxel Hikma 80 mg/4 ml Konzentrat zur Herstellung einer Infusionslösung

Primary endpoint: Overall survival is defined as time from randomisation until the date of death due to any cause. The comparison will include all randomised patients as randomised, regardless of whether the patient withdraws from therapy or receives another anticancer therapy., Radiographic Progression-free Survival (rPFS) Per Response Evaluation Criteria in Solid Tumors Version 1.1 (RECIST 1.1) for soft tissue and/or Prostate Cancer Working Group 3 (PCWG3) for bone as Assessed by the Investigator
Endpoint(s): OS is defined as time from randomisation until the date of death due to any cause., Radiographic Progression-free Survival (rPFS) Per Response Evaluation Criteria in Solid Tumors Version 1.1 (RECIST 1.1) for soft tissue and/or Prostate Cancer Working Group 3 (PCWG3) for bone as Assessed by the Investigator, Time to pain progression (TTPP) based on a 2-point increase from baseline in the Brief Pain Inventory-Short Form (BPI-SF) Item 3 'worst pain in 24 hours' score and/or initiation of/increase in opioid analgesic use, Time to start Symptomatic Skeletal-Related Event (SSRE), Time to deterioration in urinary symptoms (TTDUS), change from baseline that reaches a clinically meaningful deterioration threshold., Time to deterioration in Physical Functioning (TTDPF), change from baseline that reaches a clinically meaningful deterioration threshold., Change from baseline in BPI-SF worst pain score, pain severity and interference domain scores., Plasma concentration of capivasertib derived from a population PK model

Source: https://euclinicaltrials.eu/ctis-public/view/2023-504996-26-00